EU clinical trial 2022-501470-18-00: A Phase 2, Multicenter, Randomized, Open-Label, Active-Control Study of REGN9933, a Factor XI Monoclonal Antibody, for Prevention of Venous Thromboembolism after Elective, Unilateral, Total Knee Arthroplasty
Protocol code: R9933-DVT-2230
Sponsor: Regeneron Pharmaceuticals Inc. (Pharmaceutical company). Phase: Therapeutic exploratory (Phase II). Countries: Lithuania (ended), Latvia (ended), Poland (ended), Hungary (ended), Bulgaria (ended), Belgium (ended).
Therapeutic area(s): Diseases [C] - Hemic and Lymphatic Diseases [C15]; Diseases [C] - Cardiovascular Diseases [C14]
Gender: Female, Male. Age: 18-64 years, 65+ years. Enrolment: 408.
Status: Ended. Start date (EU): 2023-06-26. End date (EU): 2024-05-27. End date: 2024-05-28. Decision date: 2023-04-06. Results received: Yes. Last updated: 2024-04-15.
Decision dates by country: LV: 2023-04-12, BE: 2023-07-03, LT: 2023-04-06, BG: 2023-09-25, PL: 2023-04-17, HU: 2023-09-25

Condition(s): Thromboembolic disease
Product: Eliquis 2.5 mg film-coated tablets, Inhixa 4,000 IU (40 mg)/0.4 mL solution for injection in pre-filled syringe, REGN9933, CLEXANE 4 000 UI (40 mg)/0,4 ml solution injectable en seringue préremplie

Primary endpoint: The primary endpoint is the incidence of confirmed, adjudicated venous thromboembolism (VTE) through day 12 (REGN9933 vs enoxaparin).
Endpoint(s): Incidence of major bleeding (up to approximately day 12)., Incidence of clinically relevant non-major (CRNM) bleeding (up to approximately day 12)., Incidence of treatment emergent adverse events (TEAEs) (through end of study; approximately day 75)., Incidence of major VTE through day 12 (REGN9933 versus enoxaparin)., Incidence of DVT as measured by venography of the operated leg (approximately day 12; REGN9933 vs enoxaparin)., Concentrations of REGN9933 in serum (through end of study; approximately day 75)., Change in activated partial thromboplastin time (aPTT) from baseline (through end of study; approximately day 75)., Change in prothrombin time (PT) from baseline (through end of study; approximately day 75)., Incidence of anti-drug antibodies (ADA) to REGN9933 (through end of study; approximately day 75)., Titer of anti-drug antibodies (ADA) to REGN9933 (through end of study; approximately day 75)., Incidence of confirmed, adjudicated VTE (baseline through day 12; enoxaparin vs apixaban).

Source: https://euclinicaltrials.eu/ctis-public/view/2022-501470-18-00